EU clinical trial 2024-514265-19-00: Single Ascending Dose study of ENX-104
Protocol code: ENX-104-001
Sponsor: Engrail Therapeutics Inc. (Pharmaceutical company). Phase: Human Pharmacology (Phase I)- First administration to humans. Countries: Netherlands (ended).
Therapeutic area(s): Psychiatry and Psychology [F] - Mental Disorders [F03]
Gender: Female, Male. Age: 18-64 years. Enrolment: 48.
Status: Ended. Start date (EU): 2024-07-17. End date (EU): 2025-04-03. Decision date: 2024-07-16. Results received: No. Last updated: 2024-12-04.

Condition(s): Major Depressive Disorder

Source: https://euclinicaltrials.eu/ctis-public/view/2024-514265-19-00